EU clinical trial 2024-514647-29-01: EARLYPSO Early intervention in plaque psoriasis: is bimekizumab able to delay chronic inflammation? Prospective multicenter interventional study
Protocol code: 24-PP-01
Sponsor: Centre Hospitalier Universitaire De Nice (Hospital/Clinic/Other health care facility). Phase: Therapeutic exploratory (Phase II). Countries: France (ongoing, recruiting).
Therapeutic area(s): Diseases [C] - Skin and Connective Tissue Diseases [C17]
Gender: Female, Male. Age: 18-64 years. Enrolment: 40.
Status: Ongoing, recruiting. Start date (EU): 2025-07-22. Decision date: 2024-12-13. Results received: No. Last updated: 2026-08-05.

Condition(s): psoriasis
Product: DERMOVAL 0,05 %, crème, Bimzelx 160 mg solution for injection in pre-filled pen

Primary endpoint: Psoriasis clinical disease activity as assessed by PGA at both W16 and W24. Any use of topical steroids in either treatment arm would be deemed a treatment failure post W16
Endpoint(s): Psoriasis clinical disease activity as assessed by PGA at W16, 24, 48, 72, 96, - Psoriasis clinical disease activity as assessed by target PGA for the target lesion at W16, 24, 48, 72, 96, - Psoriasis clinical disease activity as assessed by PASI W0, 16, 24, 48, 72, 96, - Patient’s quality of life as assessed by DLQI at W0, 16, 24, 48, 72, 96, - Quantitative and qualitative assessment of the immune infiltrate at baseline and after 24 weeks of treatment with a special focus on resident memory T cells (Trms) and regulatory T cells (Tregs)., - Quantitative and qualitative assessment of the immune infiltrate at baseline between new and long duration psoriasis., - Time to clinical recurrence of psoriasis (first time recurrence) will be assessed in both groups (topical steroids and bimekizumab) at all time points, - Time to clinical recurrence of psoriasis (first time recurrence) will be assessed in patients with short versus long duration disease., - Topical steroid consumption and its cost compared to bimekizumab will be evaluated (on a United States cost basis) at wk 24, 48, 72 and 96

Source: https://euclinicaltrials.eu/ctis-public/view/2024-514647-29-01